EU clinical trial 2024-518566-27-00: Studio CARUSO (CARotid plaqUe StabilizatiOn and regression with evolocumab): stabilizzazione morfologica e regressione della placca carotidea con evolocumab
Protocol code: CARUSO
Sponsor: Azienda Ospedaliera Ordine Mauriziano Di Torino (Hospital/Clinic/Other health care facility). Phase: Therapeutic use (Phase IV). Countries: Italy (authorised, recruitment pending).
Therapeutic area(s): Diseases [C] - Cardiovascular Diseases [C14]
Gender: Female, Male. Age: 18-64 years, 65+ years. Enrolment: 100.
Status: Authorised, recruitment pending. Decision date: 2025-01-29. Results received: No. Last updated: 2025-01-29.

Condition(s): carotid stenosis
Product: Repatha 140 mg solution for injection in pre-filled syringe

Primary endpoint: Superiority of evolocumab added to ongoing LLT versus ongoing LLT in determining morphological stabilization and carotid plaque regression, at 6 and 12 months, respectively

Source: https://euclinicaltrials.eu/ctis-public/view/2024-518566-27-00